EU clinical trial 2022-502354-14-00: A Phase 3, Randomized, Double-Blind Study of Adjuvant Immunotherapy with Nivolumab versus Placebo after Complete Resection of Stage IIB/C Melanoma (CheckMate 76K: CHECKpoint pathway and nivoluMAb clinical Trial Evaluation 76K)
Protocol code: CA209-76K
Sponsor: Bristol-Myers Squibb Services Unlimited Company (Pharmaceutical company). Phase: Therapeutic confirmatory (Phase III). Countries: Belgium (ongoing, recruitment ended), Czechia (ongoing, recruitment ended), Germany (ongoing, recruitment ended), Italy (ongoing, recruitment ended), Netherlands (ongoing, recruitment ended), Finland (ongoing, recruitment ended), Spain (ongoing, recruitment ended), Norway (ongoing, recruitment ended), Romania (ongoing, recruitment ended), Sweden (ongoing, recruitment ended), Denmark (ongoing, recruitment ended), Austria (ongoing, recruitment ended), Greece (ongoing, recruitment ended), France (ongoing, recruitment ended), Poland (ongoing, recruitment ended).
Therapeutic area(s): Diseases [C] - Neoplasms [C04]
Gender: Female, Male. Age: 0-17 years, 18-64 years, 65+ years. Enrolment: 741.
Status: Ongoing, recruitment ended. Start date (EU): 2019-10-28. Decision date: 2023-05-09. Results received: No. Last updated: 2026-06-30.
Decision dates by country: DE: 2023-05-10, RO: 2023-05-15, NL: 2023-05-15, SE: 2023-05-10, DK: 2023-05-09, AT: 2023-06-05, BE: 2023-05-10, IT: 2023-05-15, PL: 2023-06-13, FR: 2023-06-08, GR: 2023-06-01, FI: 2023-05-10, NO: 2023-05-12, ES: 2023-05-10, CZ: 2023-05-11

Condition(s): Completely resected Stage IIb/c melanoma
Product: 0.9% sodium chloride injection. Solution for injection., OPDIVO 10 mg/mL concentrate for solution for infusion., OPDIVO 10 mg/mL concentrate for solution for infusion., 5% Dextrose for Injection; Solution for injection

Primary endpoint: RFS
Endpoint(s): OS, AE, clinical laboratory values, vital signs, ECGs, or other safety biomarkers, DMFS, Objective response rates (if applicable), Duration of treatment on next-line therapies, Progression-free survival through next-line therapy (PFS2) is defined as the time from randomization to second recurrence/objective disease progression after the start of the next-line of systemic anti-cancer therapy, or to the start of a second next-line systemic therapy, or to death from any cause, whichever occurs first, End-of-next-line-treatment: To be used for situations where PFS2 cannot be reliably determined. Event defined as end or discontinuation of next-line treatment, second objective disease progression, or death from any cause, whichever occurs first.

Source: https://euclinicaltrials.eu/ctis-public/view/2022-502354-14-00